EU clinical trial 2026-525442-30-00: The RELEASE Trial: Reconsidering Long-Term Aspirin in the Elderly in Secondary Prevention of Cardiovascular Disease
Sponsor: Odense University Hospital (Hospital/Clinic/Other health care facility). Phase: Phase III and phase IV (Integrated). Countries: Denmark (authorised, recruitment pending).
Therapeutic area(s): Diseases [C] - Cardiovascular Diseases [C14]
Gender: Female, Male. Age: 65+ years. Enrolment: 7000.
Status: Authorised, recruitment pending. Decision date: 2026-07-06. Results received: No. Last updated: 2026-07-06.

Condition(s): Ischemic heart disease/Chronic coronary syndrome (Myocardial infarction, percutaneous coronary intervention, coronary artery bypass grafting)
Product: Magnyl DAK, enterotabletter, Hjertemagnyl, filmovertrukne tabletter 75 mg

Primary endpoint: The following components are included in the primary endpoint, ranked in hierarchical order: 1. Cardiovascular death 2. Fatal bleeding (BARC type 5) 3. Intracranial bleeding (BARC type 3c) 4. Ischemic stroke 5. MI 6. Other major bleeding (BARC type 3a [moderate, requires transfusion] and 3b [major, may need surgery])
Endpoint(s): The secondary endpoints of the trial are listed below: - Each component of the primary composite outcome - All-cause mortality - Hospitalization for cardiovascular causes - Peptic ulcer - Patient-reported outcomes o Minor bleeding o Abdominal pain/discomfort o Quality of life o Health-related quality of life, anxiety and depressive symptoms, and functional status o Angina symptoms o Lifestyle behaviour

Source: https://euclinicaltrials.eu/ctis-public/view/2026-525442-30-00